EU clinical trial 2022-502298-41-00: A Phase 2, Double-Blind, Randomized Clinical Trial to Explore the Safety, Tolerability, Efficacy, and Pharmacokinetics of PRAX-562 in Pediatric Participants with Developmental and Epileptic Encephalopathies Followed by an Open-Label Extension
Protocol code: PRAX-562-221
Sponsor: Praxis Precision Medicines Inc. (Pharmaceutical company). Phase: Therapeutic exploratory (Phase II). Countries: Spain (ongoing, recruitment ended).
Therapeutic area(s): Diseases [C] - Nervous System Diseases [C10]
Gender: Female, Male. Age: 0-17 years, 18-64 years. Enrolment: 70.
Status: Ongoing, recruitment ended. Start date (EU): 2023-08-23. Decision date: 2023-05-17. Results received: No. Last updated: 2026-07-16.

Condition(s): SCN2A and SCN8A developmental and epileptic encephalopathy (SCN2A DEE and SCN8A DEE)
Product: PRAX-562 placebo powder for oral suspension, Relutrigine

Primary endpoint: Part A (Cohorts 1 and 2) & B: Incidence and severity of treatment-emergent adverse events (TEAEs), Part A (Cohorts 3 and 4): Change from baseline in monthly (28-day) motor seizure frequency
Endpoint(s): Part A (Cohorts 1 and 2) & B: Change from baseline in monthly (28-day) motor seizure frequency, Part A & B: Plasma concentrations of PRAX-562, Part A (Cohorts 3 and 4): Incidence and severity of treatment-emergent adverse events (TEAEs), Part A (Cohorts 3 and 4): Number of motor seizure-free days -CGI-I at end of treatment -CgGI-I at end of treatment

Source: https://euclinicaltrials.eu/ctis-public/view/2022-502298-41-00